EU clinical trial 2025-524404-29-00: J6E-MC-KWAM: A Randomized, Multicenter, Double-Blind, Placebo-Controlled Development Program to Evaluate the Efficacy and Safety of LY4268989 (MORF-057) for the Treatment of Adults with Moderately to Severely Active Ulcerative Colitis (EMERALD-3)
Protocol code: J6E-MC-KWAM
Sponsor: Eli Lilly & Co. (Pharmaceutical company). Phase: Therapeutic exploratory (Phase II). Countries: Latvia (authorised, recruitment pending), Portugal (authorised, recruiting), Greece (authorised, recruitment pending), France (authorised, recruiting), Czechia (authorised, recruiting), Italy (authorised, recruitment pending), Poland (ongoing, recruiting), Slovakia (authorised, recruitment pending), Hungary (authorised, recruiting), Croatia (authorised, recruitment pending), Lithuania (authorised, recruitment pending).
Therapeutic area(s): Diseases [C] - Digestive System Diseases [C06]
Gender: Female, Male. Age: 18-64 years, 65+ years. Enrolment: 104.
Start date (EU): 2026-06-24. Decision date: 2026-06-10. Results received: No. Last updated: 2026-08-07.
Decision dates by country: HR: 2026-06-23, IT: 2026-06-16, LV: 2026-06-11, SK: 2026-06-15, HU: 2026-06-15, PL: 2026-06-18, PT: 2026-06-11, LT: 2026-06-23, GR: 2026-06-10, FR: 2026-06-10, CZ: 2026-06-12

Condition(s): Ulcerative Colitis, Active Severe, Ulcerative Colitis (UC), Ulcerative Colitis, Active Moderate
Product: MORF+Adipic Acid, MORF+Adipic Acid, Placebo to match LY

Primary endpoint: Percentage of Participants Who Achieve Clinical Remission with Modified Mayo Score (mMS) [Time Frame: Week 10] Percentage of Participants Who Achieve Clinical Remission with mMS Among Participants Who Achieved Clinical Response with LY4268989 at Week 10 [Time Frame: Week 52]

Source: https://euclinicaltrials.eu/ctis-public/view/2025-524404-29-00